EU clinical trial 2024-514969-18-00: An Open-label, Multicenter, Rollover Study in Patients Who Participated in an Avapritinib Clinical Study
Protocol code: BLU-285-2404
Sponsor: Blueprint Medicines Corp. (Pharmaceutical company). Phase: Therapeutic use (Phase IV). Countries: Italy (ongoing, recruiting), Netherlands (authorised, recruiting), Belgium (authorised, recruiting), Norway (authorised, recruiting), Spain (authorised, recruitment pending), Sweden (authorised, recruitment pending).
Therapeutic area(s): Diseases [C] - Neoplasms [C04]
Gender: Female, Male. Age: 18-64 years. Enrolment: 33.
Start date (EU): 2024-11-05. Decision date: 2024-10-08. Results received: No. Last updated: 2026-07-31.
Decision dates by country: IT: 2024-10-11, BE: 2024-10-08, NO: 2024-10-21, NL: 2024-10-10, ES: 2026-07-31, SE: 2026-07-07

Condition(s): Systemic Mastocytosis
Product: Avapritinib, Avapritinib

Primary endpoint: no primary end points

Source: https://euclinicaltrials.eu/ctis-public/view/2024-514969-18-00